EU clinical trial 2024-511818-21-00: Anesthetic block of the erector muscles of the lumbar spine to relieve acute lumbar pain: pilot study
Protocol code: BLOCLOMB
Sponsor: Sante Atlantique (Hospital/Clinic/Other health care facility). Phase: Therapeutic confirmatory (Phase III). Countries: France (ongoing, recruiting).
Therapeutic area(s): Diseases [C] - Musculoskeletal Diseases [C05]
Gender: Female, Male. Age: 18-64 years, 65+ years. Enrolment: 40.
Status: Ongoing, recruiting. Start date (EU): 2026-03-06. Decision date: 2024-07-08. Results received: No. Last updated: 2026-07-21.

Condition(s): Acute law back pain
Product: DEXAMETHASONE MEDISOL 4 mg/1 ml, solution injectable, Chlorure de sodium 0.9%, ROPIVACAINE NORIDEM 7,5 mg/mL, solution injectable

Primary endpoint: The primary endpoint will be the area under the curve of NS (numeric scale) pain in activity over the first 4 days, with values reported on a monitoring log or observation book at H0-1-4-8-12 and D1-2-3-4.
Endpoint(s): NS (numeric scale) pain at rest at D4, NS pain in activity at D4, The area under the curve of the NS pain at rest is based on values recorded in a monitoring logbook and observation book at H0-4-8-12 and D1-2-3-4-7-14-21-28 days., NS pain at D4, OSWESTRY algofunctional index, Number of days off work up to D28, Complications will focus on the following adverse events: (a) injection-site hematoma, nerve damage, limb pain, convulsions, respiratory discomfort, bradycardia, severe vagal malaise (b) fall, iatrogenic infection (c) new lumbago, sciatica or complicated crural neuralgia (neurological deficit, cauda equina syndrome) (d) allergy, digestive complication, renal complication (e) other to be specified, Recording of analgesics and NSAIDs, physiotherapy, manipulations, open surgery, etc., Schober test performed at D0 and D4

Source: https://euclinicaltrials.eu/ctis-public/view/2024-511818-21-00